EU clinical trial 2024-519738-21-01: Preoperative intravenous iron therapy in patients with gastric cancer
Sponsor: HUS-Yhtymae (Hospital/Clinic/Other health care facility). Phase: Therapeutic use (Phase IV). Countries: Finland (authorised, recruitment pending).
Therapeutic area(s): Diseases [C] - Neoplasms [C04]
Gender: Female, Male. Age: 18-64 years, 65+ years. Enrolment: 202.
Status: Authorised, recruitment pending. Decision date: 2024-12-16. Results received: No. Last updated: 2024-12-16.

Condition(s): Patients with gastric cancer
Product: Ferinject 50 mg Fe/ml injektio-/infuusioneste, dispersio., Natriumklorid 9 mg/ml “Fresenius Kabi“

Primary endpoint: Number of patients receiving transfusions
Endpoint(s): Postoperative Hb level, complications and quality of life

Source: https://euclinicaltrials.eu/ctis-public/view/2024-519738-21-01